EU clinical trial 2023-506178-11-00: A phase 3, randomised, double-blind, placebo-controlled, parallel-arm efficacy trial of Imatinib in acute ischaemic stroke
Protocol code: I-Stroke II
Sponsor: Karolinska Institutet (Educational Institution). Phase: Therapeutic confirmatory (Phase III). Countries: Sweden (temporarily halted).
Therapeutic area(s): Diseases [C] - Cardiovascular Diseases [C14]
Gender: Female, Male. Age: 18-64 years, 65+ years. Enrolment: 680.
Status: Temporarily halted. Start date (EU): 2025-11-11. Decision date: 2023-11-07. Results received: No. Last updated: 2023-11-07.

Condition(s): Acute ischemic stroke
Product: IMATINIB, Imatinib placebo, powder for concentrate for solution for infusion, Imatinib 400 mg powder for concentrate for solution for infusion, Tablet placebo, Sodium Chloride, Mannitol, L-Methionine, Potassium dihydrogen phosphate, Riboflavin, Lactose Monohydrate, Hypomellose 2910, Magnesium Stearate, Colloidal Silicon Dioxide, Quinoline Yellow

Primary endpoint: Change in modified Rankin Scale (mRS) score at 3 months, favourable shift of the scale in the Imatinib group compared to placebo.
Endpoint(s): 1) Functional independency at 3 months as measured by modified Rankin Scale (mRS) Score 0-2. For a positive outcome, patients in the active group treated with Imatinib 800 mg per day will have statistically significant higher functional independency compared to the control group treated with placebo, 2) Neurological outcome at 24 h and at 7 days or discharge if occurs earlier and at 3 months, 3) Frequency and grade of ICH and cerebral oedema on post-treatment imaging scan in patients undergoing IV thrombolysis and or endovascular thrombectomy,, 4) Serious and non-serious adverse events, 5) Mortality at 3 months

Source: https://euclinicaltrials.eu/ctis-public/view/2023-506178-11-00